EU clinical trial 2024-516130-35-00: An open label, multicenter, phase II study of belantamab mafodotin in combination with VRd for the treatment of newly diagnosed transplant eligible multiple myeloma patients
Protocol code: GEM-BELA-VRd
Sponsor: Fundacion Pethema (Patient organisation/association). Phase: Therapeutic exploratory (Phase II). Countries: Spain (ended).
Therapeutic area(s): Diseases [C] - Neoplasms [C04]
Gender: Female, Male. Age: 18-64 years, 65+ years. Enrolment: 50.
Status: Ended. Start date (EU): 2024-09-26. End date (EU): 2026-03-03. Decision date: 2024-09-26. Results received: No. Last updated: 2024-09-26.

Condition(s): Multiple myeloma
Product: Lenalidomide Biocon 10 mg harde capsules, Lenalidomide Biocon 15 mg harde capsules, Melphalan Tillomed 50 mg powder and solvent for solution for injection/infusion, Lenalidomide 25mg hard capsules, Dexamethasone 20 mg tablets, Bortezomib Biotech Pharma Limited 3.5 mg powder for solution for injection

Primary endpoint: Number of participants with adverse events (AEs) during the induction therapy (six treatment cycles), Change from Baseline in hematology parameters: absolute white blood cell count (WBC), basophils, eosinophils, lymphocytes, monocytes, platelet count, and neutrophils (Giga cells per liter) the induction therapy (six treatment cycles)., Change from Baseline in hematology parameters: Red Blood Cell (RBC) count and reticulocyte count (Trillion cells per liter) the induction therapy (six treatment cycles), Change from Baseline in clinical chemistry parameters: Alanine Amino Transferase (ALT), Alkaline Phosphatase (ALP), Aspartate Amino Transferase (AST), Creatine kinase (CK), Gamma Glutamyl Transferase (GGT), and lactate dehydrogenase (LDH), Change from Baseline in clinical chemistry parameters: Calcium, chloride, glucose, potassium, sodium, magnesium, blood urea nitrogen (BUN), and phosphorous (Millimoles per Liter) during the induction therapy (six treatment cycles), Change from Baseline in clinical chemistry parameters: Creatinine, direct bilirubin, total bilirubin, uric acid (Micromoles per liter) at baseline and during the induction therapy (six treatment cycles), Number of participants with abnormal ocular findings during the induction therapy (six treatment cycles), Number of participants with symptomatic adverse effects measured by Ocular Surface Disease Index (OSDI) during the induction therapy (six treatment cycles).
Endpoint(s): Complete Response Rate (CRR), defined as the percentage of participants with a confirmed complete response (CR) or better (stringent complete response (CR, sCR))., Progression-free survival (PFS). PFS, defined as the time from the date of study inclusion until the earliest date of documented disease progression (according to International Myeloma Working Group [IMWG] Response Criteria, APPENDIX 7) or death due to any cause, PFS2, defined as time from inclusion to disease progression after initiation of new anti-cancer therapy or death from any cause, whichever is earlier. If disease progression after new anti-cancer therapy cannot be measured, a PFS event is defined as the date of discontinuation of new anti-cancer therapy, or death from any cause, whichever is earlier., Overall survival (OS). OS, defined as the time from study inclusion until death due to any cause, Overall response rate (ORR). ORR, defined as the percentage of participants with a confirmed partial response (PR) or better per IMWG, Duration of response (DoR). DoR, defined as the time from first documented evidence of PR or better until progressive disease (PD) per IMWG or death due to PD among participants who achieve confirmed PR or better, Time to response (TTR). TTR, defined as the time between the date of inclusion and the first documented evidence of response (PR or better) among participants who achieve confirmed PR or better., Time to progression (TTP). TTP, defined as the time from the date of study inclusion until the earliest date of documented PD (per IMWG Response Criteria) or death due to PD, Rate of Minimal Residual Disease (MRD). MRD negativity rate, defined as; the percentage of participants who are MRD negative by Next generation flow cytometry (NGF) method.

Source: https://euclinicaltrials.eu/ctis-public/view/2024-516130-35-00